EU clinical trial 2024-518521-14-00: Inhaled sedation in the critically ill patient: a multicentre randomised clinical trial
Protocol code: SI-CRITIC
Sponsor: Hospital Universitario La Paz (Hospital/Clinic/Other health care facility). Phase: Therapeutic use (Phase IV). Countries: Spain (ongoing, recruiting).
Therapeutic area(s): Analytical, Diagnostic and Therapeutic Techniques and Equipment [E] - Anesthesia and Analgesia [E03]
Gender: Female, Male. Age: 18-64 years, 65+ years. Enrolment: 620.
Status: Ongoing, recruiting. Start date (EU): 2025-10-17. Decision date: 2025-03-14. Results received: No. Last updated: 2026-06-08.

Condition(s): Critical condition
Product: Sedaconda 100% líquido para inhalación del vapor, Propofol Fresenius 20 mg/ml emulsión para inyección o perfusión

Primary endpoint: Mean number of days free of mechanical ventilation at day 28 from randomization.
Endpoint(s): Mean number of days free of ICU stay on day 28 from randomization., Average number of hours until extubation after withdrawal of sedation evaluated on the day of withdrawal or on day 28, whichever occurs first, from randomization., Average RASS scale score maintained during the sedation maintenance period by participants in both treatment arms., Proportion of participants that require the additon one or more hypnotics., Proportion of participants with delirium on day 28 and average number of days with delirium on day 28 (assessed using the CAM-ICU scale)., Proportion of participants who died from any cause until day 60 from randomization., Proportion of participants with symptoms of anxiety, depression or post-traumatic stress disorder 90 days after hospital discharge., Proportion of patients who present an abnormal score in the cognitive assessment 90 days after hospital discharge., Proportion of patients presenting adverse reactions in both arms., Average number of hours to awakening (RASS range from -1 to +1) after sedation withdrawal., Proportion of patients with abnormal scores on functional activity assessment (Barthel Index) at 90 days after hospital discharge.

Source: https://euclinicaltrials.eu/ctis-public/view/2024-518521-14-00